EU clinical trial 2026-526368-18-00: A Randomized Controlled Study Evaluating Short-Term Dual Antiplatelet Therapy with Low-Dose Ticagrelor (60 mg) Followed by Monotherapy versus Standard-Duration Dual Antiplatelet Therapy with Clopidogrel in Patients with Chronic Coronary Syndrome Undergoing Percutaneous Coronary Intervention: the STELAR trial
Sponsor: Azienda Ospedaliera Universitaria Gaetano Martino Messina (Hospital/Clinic/Other health care facility). Phase: Therapeutic confirmatory (Phase III). Countries: Italy (authorised, recruitment pending).
Therapeutic area(s): Diseases [C] - Cardiovascular Diseases [C14]
Gender: Female, Male. Age: 18-64 years, 65+ years. Enrolment: 500.
Status: Authorised, recruitment pending. Decision date: 2026-07-27. Results received: No. Last updated: 2026-07-27.

Condition(s): Chronic Coronary Syndrome in patients undergoing percutaneous coronary intervention (PCI)
Product: Auretica 60 mg compresse rivestite con film, CARDIOASPIRIN 100 mg Compresse gastroresistenti, Clopidogrel 75 mg film-coated tablets

Primary endpoint: Net adverse clinical events including: cardiovascular death, myocardial infarction, clinically relevant bleeding, stroke, ischemia-driven target vessel revascularization
Endpoint(s): Ischemic composite including: Cardiovascular Death, Myocardial Infarction (MI), Stroke (ischemic or hemorrhagic), Stent Thrombosis, Ischemia-driven Target Vessel Revascularization (TVR), NACE tested at 12 month, Individual components of the primary endpoint, Any Bleeding (BARC 1–5), Minor Bleeding (BARC 1–2), Unplanned Revascularization (Any Cause), All-cause mortality

Source: https://euclinicaltrials.eu/ctis-public/view/2026-526368-18-00